EU clinical trial 2024-511202-23-00: An open-label, multicenter, randomized Phase 2 study of the ATR inhibitor tuvusertib in combination with the PARP inhibitor niraparib or the ATM inhibitor lartesertib in participants with BRCA mutant and/or homologous recombination deﬁciency (HRD) positive epithelial ovarian cancer that progressed on prior PARP inhibitor therapy (DDRiver EOC 302)
Protocol code: MS201924_0002
Sponsor: Merck Healthcare KGaA (Pharmaceutical company). Phase: Therapeutic exploratory (Phase II). Countries: Denmark (ended), Spain (ongoing, recruitment ended), Germany (ended), Belgium (ended), Netherlands (ended), France (ended), Poland (ended), Italy (ongoing, recruitment ended).
Therapeutic area(s): Diseases [C] - Female Urogenital Diseases and Pregnancy Complications [C13]
Gender: Female. Age: 18-64 years, 65+ years. Enrolment: 99.
Start date (EU): 2024-10-31. Decision date: 2024-09-30. Results received: No. Last updated: 2026-04-22.
Decision dates by country: DE: 2024-10-01, PL: 2024-10-07, BE: 2024-10-02, NL: 2024-10-07, FR: 2024-10-04, ES: 2024-09-30, IT: 2024-10-03, DK: 2024-09-30

Condition(s): Epithelial ovarian cancer that progressed on prior PARP inhibitor therapy
Product: M1774, M1774, M1774, M1774, M4076, Zejula 100 mg film-coated tablets

Primary endpoint: Part A and Part B: Confirmed Objective Response (OR) According to RECIST v1.1 as Assessed by Investigator, Part A and Part B: Number of Participants With Treatment-Emergent Adverse Events (TEAE), Serious TEAEs and Related TEAEs
Endpoint(s): Part A and Part B: Duration of Response (DoR) According to RECIST 1.1 as Assessed by the Investigator, Part A and Part B: Progression Free Survival (PFS) According to RECIST 1.1 as Assessed by the Investigator, Part B: Overall Survival

Source: https://euclinicaltrials.eu/ctis-public/view/2024-511202-23-00